EU clinical trial 2024-514794-22-01: A RAndomised Placebo Controlled Trial - to Explore the Efficacy and Mechanism of Action of Tezepelumab in EGPA- RACE-MATE
Sponsor: Imperial College London Limited (Educational Institution). Phase: Therapeutic exploratory (Phase II). Countries: Italy (not authorised).
Therapeutic area(s): Diseases [C] - Respiratory Tract Diseases [C08]
Gender: Female, Male. Age: 18-64 years, 65+ years. Enrolment: 10.
Status: Not authorised. Decision date: 2025-05-02. Results received: No. Last updated: 2025-05-02.

Condition(s): Eosinophilic granulomatosis with polyangiitis (EGPA)
Product: PLACEBO, Tezspire 210 mg solution for injection in pre-filled syringe

Primary endpoint: The primary endpoint is the proportion of patients, who achieve remission at week 24 (defined as a Birmingham Vasculitis Score (BVAS) version 3 score of 0 and receipt of prednisolone of ≤ 4mg daily and no receipt of oral steroids above baseline dose in the 4 weeks prior to week 24).
Endpoint(s): (I) Time to first EGPA flare. (II) Total accrued weeks of remission defined as defined as a Birmingham Vasculitis Activity Score (BVAS) – version 3(11), score of 0 with mOCS dose of prednisolone/prednisolone ≤ 4mg/day and BVAS of 0.

Source: https://euclinicaltrials.eu/ctis-public/view/2024-514794-22-01